EU clinical trial 2025-524580-21-00: A prospective, randomized, double-blind, placebo-controlled, multicentre, dose-finding clinical trial with polymerised mannan-conjugated allergoid Dactylis glomerata/Phleum pratense administered subcutaneously to patients with grass pollen-induced allergic rhinitis or rhinoconjunctivitis.
Protocol code: MG58-SIT-084
Sponsor: Inmunotek S.L. (Pharmaceutical company). Phase: Phase II and Phase III (Integrated). Countries: Germany (ongoing, recruitment ended).
Therapeutic area(s): Diseases [C] - Immune System Diseases [C20]
Gender: Female, Male. Age: 18-64 years. Enrolment: 450.
Status: Ongoing, recruitment ended. Start date (EU): 2026-06-01. Decision date: 2026-05-29. Results received: No. Last updated: 2026-05-29.

Condition(s): Grass pollen induced allergic rhinitis or rhinoconjunctivitis
Product: Mometason ratiopharm 50 Mikrogramm/Sprühstoß Nasenspray, Suspension, Placebo is identical in appearance an condition to the investigational medicinal product., Budes 64 Mikrogramm/Sprühstoß Nasenspray, Suspension, Allegra Allergietabletten 20 mg Tabletten, NASACORT 55 Mikrogramm/Dosis Nasenspray, Suspension, HAL Allergy Prick Test Wiesenlieschgras, EMADINE 0.5 mg/ml, eye drops, solution, Ebastin Aristo 10 mg Filmtabletten, Cetirizin-ratiopharm® bei Allergien Filmtabletten, Desloratadin Glenmark 5 mg Tabletten, Fexofenadin Winthrop 180 mg Filmtabletten, AVAMYS 27.5 micrograms/spray, nasal spray suspension, Bilaxten 6 mg/ml Augentropfen, Lösung, HAL Allergy Prick Test Katzenepithelien, Olopatadin Micro Labs 1 mg/ml Augentropfen, Lösung, Mannan-conjugated allergoid (polymerized) Phleum pratense and Dactylis glomerata parenteral vaccine, ALK Prick Positiv Kontrolle - Lösung für Haut-Pricktest, Rupatadin AL 10 mg Tabletten, HAL Allergy Prick Test Hundeepithelien, HAL Allergy Pricktest 10 mg/ml Pricktestlösung zur Positivkontrolle, HAL Allergy Prick Test Alternaria alternata, Azelastin COMOD 0,5 mg/ml Augentropfen, HAL Allergy Prick Test Gräserpollen-Mischung, Levocetirizin-ratiopharm 5 mg Filmtabletten, HAL Allergy Prick Test Hausstaubmilbe Dermatophagoides Pteronyssinus, Livocab® direkt Augentropfen 0,05 % Augentropfen, Suspension, Loratadin-ratiopharm® 10 mg Tabletten, ALK Prick Negativ Kontrolle - Lösung für Haut-Pricktest, HAL Allergy Pricktest Negativkontrolle, Pricktestlösung, Alvesco 160 Mikrogramm Druckgasinhalation, Lösung, Flutica-Teva® 50 Mikrogramm Nasenspray, Suspension

Primary endpoint: Mean daily Combined Symptom and Medication Score (CSMS, as defined in the EAACI position paper by Pfaar et al., 2014) over the peak grass pollen season 2027.

Source: https://euclinicaltrials.eu/ctis-public/view/2025-524580-21-00